EU clinical trial 2022-502755-59-00: A Phase 1 study of LOXO-435 in Locally Advanced or Metastatic Solid Tumors with FGFR3 Gene Alterations
Protocol code: LOXO-FG3-22001
Sponsor: Eli Lilly & Co. (Pharmaceutical company). Phase: Human Pharmacology (Phase I)- First administration to humans. Countries: Netherlands (ongoing, recruiting), Italy (ongoing, recruiting), Germany (ongoing, recruiting), France (ongoing, recruiting), Norway (ongoing, recruiting), Spain (ongoing, recruiting).
Therapeutic area(s): Diseases [C] - Neoplasms [C04]
Gender: Female, Male. Age: 18-64 years, 65+ years. Enrolment: 85.
Status: Ongoing, recruiting. Start date (EU): 2023-08-30. Decision date: 2023-06-28. Results received: No. Last updated: 2026-05-19.
Decision dates by country: ES: 2023-07-10, IT: 2023-07-21, NL: 2023-07-03, NO: 2023-06-28, DE: 2023-07-10, FR: 2023-07-11

Condition(s): Locally Advanced or Metastatic Solid Tumors with FGFR3 Alterations

Source: https://euclinicaltrials.eu/ctis-public/view/2022-502755-59-00